EU clinical trial 2023-507778-42-00: A Phase II Multicenter, open label, non-randomized study of neoadjuvant and Adjuvant Treatment with IPH5201 and durvalumab in patients with resectable, early-Stage (II to III) Non-Small Cell Lung Cancer (MATISSE)
Protocol code: IPH5201-201
Sponsor: Innate Pharma (Pharmaceutical company). Phase: Therapeutic exploratory (Phase II). Countries: Hungary (ongoing, recruiting), Greece (ongoing, recruiting), Poland (ongoing, recruiting), France (ongoing, recruiting).
Therapeutic area(s): Diseases [C] - Neoplasms [C04]
Gender: Female, Male. Age: 18-64 years. Enrolment: 69.
Status: Ongoing, recruiting. Start date (EU): 2023-03-08. Decision date: 2024-07-17. Results received: No. Last updated: 2026-07-16.
Decision dates by country: HU: 2024-07-17, GR: 2024-07-22, FR: 2024-07-22, PL: 2024-07-29

Condition(s): Non-Small Cell Lung Cancer II, III
Product: IMFINZI 50 mg/mL concentrate for solution for infusion., CARBOPLATIN, CISPLATIN, IMFINZI 50 mg/mL concentrate for solution for infusion., PACLITAXEL, IPH5201, IMFINZI 50 mg/mL concentrate for solution for infusion., IMFINZI 50 mg/mL concentrate for solution for infusion., PEMETREXED

Primary endpoint: pCR is defined as lack of any viable tumor cells after complete evaluation in the resected lung cancer specimen and all sampled regional lymph nodes.. The measure of interest is the proportion of patients with0% residual viable tumor cells within all resected tissue as assessed by the central pathologist. -Safety and tolerability will be evaluated in terms of adverse events, vital signs, and clinical laboratory.
Endpoint(s): 1. EFS is defined as the time from neoadjuvant Cycle 1 Day 1 to the first of the following: -Documented local or distant recurrence of lung cancer as determined by the Investigator using RECIST 1.1 assessment. -Death due to any cause (event date is date of death)., 2. EFS is defined as the time from neoadjuvant Cycle 1 Day 1 to the first of the following: PD that precludes surgery (event date is the date of this determination) or PD discovered and reported by the Investigator upon attempting surgery (event date is the date of the first attempt at surgery). The measure of interest is the median of EFS and landmark EFS at 12 months, 3. DFS is defined as the time from the date of surgery until the first date of disease recurrence as determined by Investigator using RECIST 1.1 assessment (local or distant), or date of death due to any cause, whichever occurs first. Pathological confirmation from biopsied lesions will also be taken into consideration (as applicable).., 4. Feasibility to surgery is defined as having the planned surgical resection within 40 days from the end of the last dose of neoadjuvant treatment. The measure of interest is the proportion of patients who have intended surgery within 40 days from the end of last dose of neoadjuvant treatment., 5. mPR is defined as ≤ 10% viable tumor cells in resected tumor after complete evaluation in the resected lung cancer specimen as determined by central independent pathological review and described by IASLC 2020). The measure of interest is the proportion of patients with ≤ 10% residual viable tumor cells within all resected tissue as assessed by the central pathologist., 7. OS is defined as the time from neoadjuvant Cycle 1 Day 1 until the date of death due to any cause. The measure of interest is the median of the overall OS and landmark OS at 12 months., 6. ORR is defined as the proportion of patients who have a complete response (CR) or partial response (PR)), as determined by Investigator using RECIST 1.1. Data obtained from neoadjuvant Cycle 1 Day 1 up until surgery, or the last evaluable assessment in the absence of progression, prior to surgery, will be included in the assessment of ORR, regardless of whether the patient withdraws therapy

Source: https://euclinicaltrials.eu/ctis-public/view/2023-507778-42-00